EU clinical trial 2024-518548-19-00: Albendazole pharmacokinetics in plasma, intra-cystic fluid and cystic tissue of human cystic and alveolar echinococcosis
Sponsor: Medical University Of Vienna (Educational Institution). Phase: Human Pharmacology (Phase I)- Other. Countries: Austria (ended).
Therapeutic area(s): Diseases [C] - Parasitic Diseases [C03]
Gender: Female, Male. Age: 18-64 years, 65+ years. Enrolment: 24.
Status: Ended. Start date (EU): 2023-03-27. End date (EU): 2026-03-06. Decision date: 2024-10-29. Results received: No. Last updated: 2024-10-29.

Condition(s): Human echinococcosis

Source: https://euclinicaltrials.eu/ctis-public/view/2024-518548-19-00